EU clinical trial 2023-507261-25-00: A Phase 3, Single-arm, Multicenter Study to Evaluate the Efficacy and Safety of UGN-103, a Novel Formulation of UGN-102, for the Treatment of Patients With Low Grade (LG) Nonmuscle Invasive Bladder Cancer (NMIBC) at Intermediate Risk (IR) of Recurrence (UTOPIA)
Protocol code: BL013
Sponsor: Urogen Pharma Ltd. (Pharmaceutical company). Phase: Therapeutic confirmatory (Phase III). Countries: Romania (ongoing, recruitment ended), Spain (ongoing, recruitment ended), Bulgaria (ongoing, recruitment ended), Latvia (ongoing, recruitment ended), Estonia (ongoing, recruitment ended).
Therapeutic area(s): Diseases [C] - Neoplasms [C04]
Gender: Female, Male. Age: 18-64 years, 65+ years. Enrolment: 57.
Status: Ongoing, recruitment ended. Start date (EU): 2024-10-03. Decision date: 2024-08-14. Results received: No. Last updated: 2026-05-19.
Decision dates by country: BG: 2024-08-16, EE: 2024-08-19, LV: 2024-08-15, RO: 2024-08-19, ES: 2024-08-14

Condition(s): Nonmuscle Invasive Bladder Cancer
Product: UGN-103 (Mitomycin)

Primary endpoint: CRR, defined as the proportion of patients who achieved CR at the 3-month Visit (3 months after the first instillation of UGN-103) as determined by cystoscopy, for cause biopsy, and urine cytology.
Endpoint(s): 1. DOR in patients who achieved CR at the 3-m Visit, defined as the time from the date of evidence of CR at the 3-m Visit to the earliest date of recurrence or progression as determined using the date of cystoscopy, for cause biopsy, or cytology, or death due to any cause, whichever occurred first., 2. Safety and tolerability will be evaluated through the reporting of AEs, including SAEs and AESIs, and through standard clinical and l laboratory tests (eg, hematology and chemistry, urinalysis, physical examination, and vital signs), 3. Concentration data and PK parameters (Cmax, tmax, and AUC, Exploratory 1. Changes from baseline in patient scores on the QLQ-C30 and TSQM questionnaires, Exploratory 2. DNA, RNA and/or protein biomarkers in tumor tissue, Exploratory 3. Number (%) of response outcomes evaluated at the first disease assessment visit after SoC

Source: https://euclinicaltrials.eu/ctis-public/view/2023-507261-25-00